EU clinical trial 2026-525594-39-00: Multicenter, randomized, double-blind, parallel-group clinical study comparing RD03/2016 (levoFloxacin and ketorolac trometAmol) eye drops vs Leviosa® (levofloxacin and dexamethaSone 21-phosphaTe) eye drops for 7 days for the prevention and treatment of inflammation and prevention of infection associated with cataract surgery in adults. (FAST 7)
Protocol code: Levoketo_01-2026
Sponsor: Ntc S.r.l. (Pharmaceutical company). Phase: Therapeutic confirmatory (Phase III). Countries: Spain (authorised, recruitment pending), Poland (authorised, recruitment pending), Greece (authorised, recruitment pending), Sweden (authorised, recruitment pending), Italy (authorised, recruitment pending).
Therapeutic area(s): Diseases [C] - Eye Diseases [C11]
Gender: Female, Male. Age: 18-64 years, 65+ years. Enrolment: 536.
Status: Authorised, recruitment pending. Decision date: 2026-07-07. Results received: No. Last updated: 2026-07-29.
Decision dates by country: PL: 2026-07-29, SE: 2026-07-29, IT: 2026-07-29, GR: 2026-07-29, ES: 2026-07-17

Condition(s): Cataract
Product: Leviosa® 1 mg/ml + 5 mg/ml, collirio, soluzione, levofloxacin 5mg/ml and ketorolac trametamol 5mg/ml

Primary endpoint: The proportion of patients with «absence of signs of anterior chamber inflammation (cells and flare)» after 7 days of treatment (Day 8).
Endpoint(s): Proportion of patients with conjunctival hyperemia at Day 8., Proportion of patients with ocular pain/discomfort at Day 8., Proportion of patient using rescue therapy during treatment., Proportion of patients with onset endophthalmitis at Day 8.

Source: https://euclinicaltrials.eu/ctis-public/view/2026-525594-39-00